EU clinical trial 2024-518022-33-00: HD21 for advanced stages - Treatment optimization trial in the first-line treatment of advanced stage Hodgkin lymphoma; comparison of 4-6 cycles of escalated BEACOPP with 4-6 cycles of BrECADD
Protocol code: Uni-Koeln-1762
Sponsor: University Of Cologne (Educational Institution). Phase: Therapeutic confirmatory (Phase III). Countries: Norway (ended), Austria (ended), Netherlands (ended), Germany (ended), Denmark (ended), Sweden (ended).
Therapeutic area(s): Diseases [C] - Neoplasms [C04]
Gender: Female, Male. Age: 18-64 years, 65+ years. Enrolment: 1320.
Status: Ended. Start date (EU): 2016-07-15. End date (EU): 2024-12-01. End date: 2024-12-02. Decision date: 2024-10-31. Results received: Yes. Last updated: 2024-11-19.
Decision dates by country: AT: 2024-11-19, DK: 2024-11-04, DE: 2024-11-01, SE: 2024-10-31, NL: 2024-11-05, NO: 2024-11-07

Condition(s): Advanced Stage of Hodgkin Lymphoma
Product: ADCETRIS 50 mg powder for concentrate for solution for infusion, DOXORUBICIN HYDROCHLORIDE, DEXAMETHASONE, PROCARBAZINE HYDROCHLORIDE, BLEOMYCIN SULFATE, VINCRISTINE SULFATE, PREDNISONE, DACARBAZINE, ETOPOSIDE PHOSPHATE, CYCLOPHOSPHAMIDE MONOHYDRATE, ETOPOSIDE

Primary endpoint: Randomized main study: Treatment-related morbidity (TRMB), Randomized main study: Progression-free survival (PFS), Cohort of older patients: Complete remission (CR) rate after chemotherapy
Endpoint(s): Randomized main study: Tumor response (CR rate), Randomized main study: Overall survival (OS), Randomized main study: Infertility rate at 1 year, Randomized main study: Second malignancies, Randomized main study: Quality of life (QoL), Randomized main study: Frequency of adverse events, Randomized main study: Therapy adherence, Randomized main study: Event-free Survival (EFS), Cohort of older Patients: TRMB, Cohort of older patients: PFS, Cohort of older patients: OS, Cohort of older patients: Time to progression (PFSHL) and HL-specific survival (OSHL)

Source: https://euclinicaltrials.eu/ctis-public/view/2024-518022-33-00